EU clinical trial 2025-521382-27-00: A Phase 2b/3 Randomized, Double-blind, Placebo-Controlled, Parallel Group, Multicenter Protocol to Evaluate the Efficacy and Safety of Icotrokinra in Participants With Moderately to Severely Active Crohn's Disease
Protocol code: 77242113CRD3001
Sponsor: Janssen Cilag International (Pharmaceutical company). Phase: Phase II and Phase III (Integrated). Countries: Netherlands (authorised, recruiting), Italy (ongoing, recruiting), Portugal (ongoing, recruiting), Spain (ongoing, recruiting), Czechia (ongoing, recruiting), Romania (ongoing, recruiting), France (ongoing, recruiting), Sweden (ongoing, recruiting), Hungary (ongoing, recruiting), Belgium (ongoing, recruiting), Germany (ongoing, recruiting), Greece (ongoing, recruiting), Poland (ongoing, recruiting).
Therapeutic area(s): Diseases [C] - Immune System Diseases [C20]
Gender: Female, Male. Age: 18-64 years, 65+ years. Enrolment: 435.
Start date (EU): 2025-12-04. Decision date: 2025-12-01. Results received: No. Last updated: 2026-07-06.
Decision dates by country: BE: 2025-12-02, CZ: 2025-12-04, FR: 2025-12-02, DE: 2026-02-13, GR: 2025-12-02, HU: 2025-12-05, IT: 2025-12-02, RO: 2025-12-08, ES: 2025-12-03, SE: 2025-12-01, NL: 2025-12-04, PL: 2026-02-03, PT: 2025-12-02

Condition(s): Moderately to Severely Active Crohn's Disease
Product: JNJ-77242113, Icotrokinra, JNJ-77242113-AAC Placebo tablet

Primary endpoint: Phase 2b Induction: clinical response at Week I-12 Phase 3 Induction: - Co-primary endpoints - Clinical remission at Week I-12 - Endoscopic response at Week I-12 Phase 3 Maintenance: - co-primary endpoints: - Clinical remission at Week M-40 - Endoscopic response at Week M-40

Source: https://euclinicaltrials.eu/ctis-public/view/2025-521382-27-00